EU clinical trial 2024-516595-15-00: Phase I-II, Single-Center, Randomized, Double-blind, Placebo-controlled Clinical Trial to determine the safety and efficacy of the use of allogeneic adipose tissue adult stem mesenchymal cells in the treatment of draining fistulas in patients with hidradenitis suppurativa.
Protocol code: HidraQureS/2020
Sponsor: Red Andaluza De Diseno Y Traslacion De Terapias Avanzadas Fundacion Publica Andaluza Progreso Y Salud (Hospital/Clinic/Other health care facility). Phase: Phase I and Phase II (Integrated)- Other. Countries: Spain (temporarily halted).
Therapeutic area(s): Diseases [C] - Skin and Connective Tissue Diseases [C17]
Gender: Female, Male. Age: 18-64 years, 65+ years. Enrolment: 30.
Status: Temporarily halted. Start date (EU): 2024-11-11. Decision date: 2024-11-11. Results received: No. Last updated: 2026-03-11.

Condition(s): Hidradenitis suppurativa
Product: Mixture of: 50% hyaluronic acid, 49% DMEM without phenol red and 1% L-Alanine-L Glutamine, Allogenic adipose-derived adult mesenchymal stem cells expanded

Primary endpoint: SAFETY: During the intervention, in the 24 hours afterwards and throughout the 24 months that the follow-up will last, adverse events, serious adverse events related to the investigational drug during the infusion will be evaluated as the main variable., EFFICACY: The combined remission of the treated draining fistula, defined as one that simultaneously meets the 4 criteria: Closure of all draining fistulous orifices present at the time of the inclusion of the patient in the study; Absence of suppuration after the vigorous digital pressure on the fistula; Absence of collections larger than 2 cm in the treated fistula, evaluated by blind ultrasound; And absence of inflammation evaluated by blind doppler ultrasound, in the 2 axes of the lesion.
Endpoint(s): Anatomical characteristics of the treated draining fistula: Location (armpits, groin, glutes, genital, perianal, submammary, others); Dimensions; Depth; And inflammatory activity., Clinical remission of the treated draining fistula, defined as the closure of all the draining fistula orifices at the beginning of the trial and absence of suppuration after application of vigorous digital pressure on the fistula., Evaluation of variations in the following symptoms: pain, functional limitation, pruritus, suppuration and bad odor measured by using a visual analogue scale (VAS), throughout follow-up., Changes in health-related quality of life assessed using the Euroqol-5D-3L questionnaire, throughout follow-up., Pro-inflammatory biomarkers: determination of TNFa, IL17a, IL-1a, IL-6, IL1Ra, IL-8 and VEGF, in plasma.

Source: https://euclinicaltrials.eu/ctis-public/view/2024-516595-15-00